EU clinical trial 2022-501243-33-00: A Phase 2 Open-label Clinical Study to Evaluate the Efficacy and Safety of Zilovertamab Vedotin (MK-2140) in Participants With Relapsed or Refractory Diffuse Large B-Cell Lymphoma(waveLINE-004)
Protocol code: MK2140-004
Sponsor: Merck Sharp & Dohme LLC (Pharmaceutical company). Phase: Therapeutic exploratory (Phase II). Countries: Estonia (ended), Spain (ended), Norway (ended), France (ended), Czechia (ended), Poland (ended), Greece (ended), Sweden (ended), Italy (ended).
Therapeutic area(s): Diseases [C] - Neoplasms [C04]
Gender: Female, Male. Age: 18-64 years, 65+ years. Enrolment: 59.
Status: Ended. Start date (EU): 2022-02-03. End date (EU): 2026-04-21. End date: 2026-04-22. Decision date: 2023-04-27. Results received: No. Last updated: 2025-10-16.
Decision dates by country: ES: 2023-04-27, FR: 2023-05-04, NO: 2023-05-12, PL: 2023-05-16, CZ: 2023-05-11, SE: 2023-04-27, IT: 2023-05-15, GR: 2023-05-17, EE: 2023-05-01

Condition(s): Diffuse Large B Cell Lymphoma (a type of non-Hodgkin’s lymphoma, in patients who failed prior therapies)
Product: Zilovertamab vedotin, Zilovertamab vedotin

Primary endpoint: Objective Response Rate (ORR) per Lugano Response Criteria
Endpoint(s): Duration of Response (DOR) per Lugano Response Criteria 1, Number of Participants Who Experience an Adverse Event (AE), Number of Participants Who Discontinue Study Treatment Due to an AE

Source: https://euclinicaltrials.eu/ctis-public/view/2022-501243-33-00